EU clinical trial 2023-504026-19-01: Prospective, Multi-Center Study to Assess the Diagnostic Performance of [18F]PSMA-1007 PET/CT Imaging in Patients with Newly-Diagnosed High-Risk or Very-High-Risk Prostate Cancer
Protocol code: ABX-CT-302EU/EAGLE-i
Sponsor: Abx Advanced Biochemical Compounds - Biomedizinische Forschungsreagenzien GmbH (Pharmaceutical company). Phase: Therapeutic confirmatory (Phase III). Countries: Spain (ongoing, recruiting), Netherlands (ongoing, recruiting), France (ended), Germany (ongoing, recruiting), Italy (ongoing, recruiting).
Therapeutic area(s): Analytical, Diagnostic and Therapeutic Techniques and Equipment [E] - Diagnosis [E01]; Diseases [C] - Neoplasms [C04]
Gender: Male. Age: 18-64 years, 65+ years. Enrolment: 355.
Start date (EU): 2024-06-05. Decision date: 2024-01-12. Results received: No. Last updated: 2026-07-03.
Decision dates by country: FR: 2024-01-12, IT: 2024-08-23, ES: 2024-01-11, NL: 2024-10-18, DE: 2024-01-12

Condition(s): Prostate Cancer
Product: RADELUMIN 2000 MBq/ml solution injectable, Radelumin 2000 MBq/mL solución inyectable, RADELUMIN 1300 MBq/ml solution injectable, RADELUMIN 1300 MBq/ml solution injectable, Radelumin 2000 MBq/ml Injektionslösung, RADELUMIN 1300 MBq/ml solution injectable, RADELUMIN 2000 MBq/ml solution injectable, Radelumin 1300 MBq/ml oplossing voor injectie, RADELUMIN 2000 MBq/ml solution injectable, Radelumin 1300 MBq/ml Injektionslösung, Radelumin 2000 MBq/ml oplossing voor injectie, Radelumin 1300 MBq/mL solución inyectable

Primary endpoint: Confidential commercial information

Source: https://euclinicaltrials.eu/ctis-public/view/2023-504026-19-01